EU clinical trial 2024-517438-16-00: Treatment of congenital nephrogenic diabetes insipidus with fluconazole, an antifungal medication
Sponsor: Odense University Hospital (Hospital/Clinic/Other health care facility). Phase: Therapeutic exploratory (Phase II). Countries: Denmark (ended).
Therapeutic area(s): Diseases [C] - Congenital, Hereditary, and Neonatal Diseases and Abnormalities [C16]
Gender: Male. Age: 18-64 years, 65+ years. Enrolment: 10.
Status: Ended. Start date (EU): 2024-09-12. End date (EU): 2026-02-19. Decision date: 2024-09-12. Results received: No. Last updated: 2025-12-09.

Condition(s): Nephrogenic diabetes insipidus
Product: FLUCONAZOLE

Primary endpoint: Spontaneous urinary volume and urinary concentration ability (osmolality).
Endpoint(s): Plasma osmolality, abundance of AQP2 in urinary exosomes, plasma vasopressin/copeptin concentrations, plasma electrolytes, micturition frequency

Source: https://euclinicaltrials.eu/ctis-public/view/2024-517438-16-00